EU clinical trial 2024-512288-29-00: ETOP 18-21 AMAZE-lung: A multicentre single-arm phase II trial of amivantamab, lazertinib plus bevacizumab in patients with EGFR-mutant advanced NSCLC with progression on previous third-generation EGFR-TKI.
Sponsor: ETOP IBCSG Partners Foundation (Laboratory/Research/Testing facility). Phase: Therapeutic exploratory (Phase II). Countries: Italy (ongoing, recruitment ended), Netherlands (ongoing, recruitment ended), Spain (ongoing, recruitment ended), France (ongoing, recruitment ended).
Therapeutic area(s): Diseases [C] - Neoplasms [C04]; Diseases [C] - Respiratory Tract Diseases [C08]
Gender: Female, Male. Age: 18-64 years, 65+ years. Enrolment: 30.
Status: Ongoing, recruitment ended. Start date (EU): 2023-04-11. Decision date: 2024-10-03. Results received: No. Last updated: 2026-03-30.
Decision dates by country: NL: 2024-10-14, FR: 2024-10-03, ES: 2024-10-14, IT: 2024-10-14

Condition(s): Patients with EGFR-mutant (L858R or del19 only) advanced non-squamous NSCLC, who have progressed on previous treatment with a third-generation EGFR-TKI.
Product: JNJ-73841937, JNJ-61186372, Zirabev 25 mg/ml concentrate for solution for infusion.

Primary endpoint: Objective response rate (ORR) at 12 weeks according to RECIST v1.1
Endpoint(s): • Duration of Response (DoR) • Progression-free survival (PFS) according to RECIST v1.1 • Disease control rate (DCR) according to RECIST v1.1 • Overall survival (OS) • Safety and tolerability (CTCAE v5.0)

Source: https://euclinicaltrials.eu/ctis-public/view/2024-512288-29-00